EU clinical trial 2024-516358-23-00: GASTRICHIP TRIAL. D2 resection and HIPEC (Hyperthermic IntraPeritoneal Chemoperfusion) in locally advanced gastric carcinoma. A randomized and multicentric phase III study
Protocol code: 2012-761
Sponsor: Hospices Civils De Lyon (Hospital/Clinic/Other health care facility). Phase: Therapeutic confirmatory (Phase III). Countries: France (ended).
Therapeutic area(s): Diseases [C] - Digestive System Diseases [C06]
Gender: Female, Male. Age: 18-64 years, 65+ years. Enrolment: 367.
Status: Ended. Start date (EU): 2013-06-24. End date (EU): 2026-06-30. Decision date: 2024-08-26. Results received: No. Last updated: 2026-07-03.

Condition(s): Gastric adenocarcinoma
Product: CALCIUM LEVOFOLINATE, OXALIPLATIN, FLUOROURACIL

Primary endpoint: Overall survival
Endpoint(s): Recurrence-free survivals (peritoneal recurrence, locoregional recurrence, metastatic recurrence, site of recurrence ), Treatment-related toxicity, Treatment-related mortality, Treatment related morbidity, Quality of life

Source: https://euclinicaltrials.eu/ctis-public/view/2024-516358-23-00